EU clinical trial 2022-502048-10-00: A phase-2, multi-centre, prospective, randomized, standard-of-care plus placebo-controlled, patient and central evaluator blinded, parallel arm, clinical study to evaluate safety, tolerability and efficacy of the recommended phase-2 dose of AUP1602-C in two dosing frequencies as a topical treatment for non-healing neuro-ischemic diabetic foot ulcers
Protocol code: AT-W-CLI-2022-04
Sponsor: Aurealis Oy (Pharmaceutical company). Phase: Therapeutic exploratory (Phase II). Countries: Poland (ended), Italy (ended), Germany (ended).
Therapeutic area(s): Diseases [C] - Skin and Connective Tissue Diseases [C17]
Gender: Female, Male. Age: 18-64 years, 65+ years. Enrolment: 100.
Status: Ended. Start date (EU): 2023-07-21. End date (EU): 2025-10-09. Decision date: 2023-05-05. Results received: No. Last updated: 2025-10-09.
Decision dates by country: DE: 2023-05-08, PL: 2023-05-08, IT: 2023-05-05

Condition(s): diabetic foot ulcers
Product: reconstitution solution containing: 5% dextrose, 2.5% sodium chloride, 1.6% sodium acetate in sterile water; pH: 6.0-6.5

Primary endpoint: Incidence of adverse events (AEs), Proportion of patients, receiving the RP2D of AUP1602-C in one of both dosing frequencies, and placebo achieving complete wound closure within 20 weeks after first IMP (i.e., either AUP1602-C or placebo) administration
Endpoint(s): Percentage of wound area reduction at 4, 8, 12, 16 and 20 weeks after first IMP (AUP1602-C or placebo) administration, Time to complete wound closure (Timeframe: within 20 weeks after first IMP (AUP1602-C or placebo) administration), Time to >50% wound area reduction (Timeframe: within 20 weeks after first IMP (AUP1602-C or placebo) administration), Time to >75% wound area reduction (Timeframe: within 20 weeks after first IMP (AUP1602-C or placebo) administration), Proportion of patients with complete wound closure (Timeframe: Weeks 4, 8, 12, 16 and 20 after first IMP (AUP1602-C or placebo) administration), Proportion of patients with a >50% wound area reduction (Timeframe: Weeks 4, 8, 12, 16 and 20 after first IMP (AUP1602-C or placebo) administration), Proportion of patients with a >75% wound area reduction (Timeframe: Weeks 4, 8, 12, 16 and 20 after first IMP (AUP1602-C or placebo) administration), Proportion of patients with a target ulcer recurrence (Timeframe: Weeks 8, 12, 16 and 20 after first AUP1602-C/placebo administration, and 6 and 12 Months after last IMP (AUP1602-C or placebo) administration), Percentage of wound volume and depth reduction (Timeframe: Weeks 4, 8, 12, 16 and 20 after first IMP (AUP1602-C or placebo) administration), Change from baseline in health-related QoL using the EuroQol-5D (EQ-5D) visual analogue scale (VAS), the EQ-5D utility index, and the Dermatology Life Quality Index (DLQI) score (Timeframe: Weeks 4, 8, 12, 16 and 20 after first IMP (AUP1602-C or placebo) administration), Change from baseline in patient’s pain intensity using a numerical rating scale (NRS, ranging from 0 = no pain to 10 = worst imaginable pain) (Timeframe: Weeks 4, 8, 12, 16 and 20 after first IMP (AUP1602-C or placebo) administration), Incidence and prevalence of target ulcer related periwound skin maceration events (Timeframe: during run-in period, and Weeks 4, 8, 12, 16 and 20 after first IMP (AUP1602-C or placebo) administration), Incidence and prevalence of target ulcer related local wound infection events (Timeframe: during run-in period, Weeks 4, 8, 12, 16 and 20 after first IMP (AUP1602-C or placebo) administration, and 6 and 12 Months after last IMP (AUP1602-C or placebo) administration), Incidence of surgical procedures related to the target ulcer (Timeframe: during run-in period, Weeks 4, 8, 12, 16 and 20 after first IMP (AUP1602-C or placebo) administration, and 6 and 12 Months after last IMP (AUP1602-C or placebo) administration, Incidence of target ulcer related amputation events (Timeframe: during run-in period, Weeks 4, 8, 12, 16 and 20 after first IMP (AUP1602-C or placebo) administration, and 6 and 12 Months after last IMP (AUP1602-C or placebo) administration), Number of target ulcer related hospital visits during run-in, treatment and post-treatment efficacy and safety follow-up periods, Number of patient-days of target ulcer related antibiotic therapy during run-in, treatment and post-treatment efficacy and safety follow-up periods, Number of patient-days of hospitalization due to complications related to target ulcer during run-in, treatment and post-treatment efficacy and safety follow-up periods

Source: https://euclinicaltrials.eu/ctis-public/view/2022-502048-10-00